EU clinical trial 2024-516412-17-00: A Phase 3, Randomized, Double-Blind, Placebo-Controlled, Multicenter Study to Investigate the Efficacy, Safety, and Tolerability of LP352 in the Treatment of Seizures in Children and Adults with Developmental and Epileptic Encephalopathies
Protocol code: LP352-301
Sponsor: Longboard Pharmaceuticals Inc. (Pharmaceutical company). Phase: Therapeutic confirmatory (Phase III). Countries: Portugal (ongoing, recruitment ended), Netherlands (ongoing, recruitment ended), Germany (ongoing, recruitment ended), France (ongoing, recruitment ended), Spain (ongoing, recruitment ended), Italy (ongoing, recruitment ended), Belgium (ongoing, recruitment ended), Latvia (ended), Czechia (ended), Finland (ended), Denmark (ended).
Therapeutic area(s): Diseases [C] - Nervous System Diseases [C10]
Gender: Female, Male. Age: 0-17 years, 18-64 years, 65+ years. Enrolment: 183.
Start date (EU): 2025-08-26. Decision date: 2025-06-11. Results received: No. Last updated: 2026-06-24.
Decision dates by country: FR: 2025-06-16, ES: 2025-06-25, DE: 2025-06-11, IT: 2025-06-11, PT: 2025-06-16, BE: 2025-06-13, CZ: 2026-05-25, FI: 2026-05-12, DK: 2026-05-18, NL: 2025-06-11, LV: 2025-06-12

Condition(s): Developmental and Epileptic Encephalopathies (DEE)
Product: Bexicaserin, LP352 (bexicaserin) Placebo Oral Solution

Primary endpoint: Frequency percent change in countable motor seizures during Maintenance compared to Baseline
Endpoint(s): 1.• 50% responder rate (the percentage of participants with a ≥50% reduction in countable motor seizures) during Maintenance compared to Baseline• Frequency percent change in countable motor seizures during Treatment compared to Baseline

Source: https://euclinicaltrials.eu/ctis-public/view/2024-516412-17-00